EU clinical trial 2025-520599-24-00: An open-label, single group, single-dose clinical study to evaluate the usability of the pre-filled syringe (PFS) of SB11 in trial participants with Neovascular Age-Related Macular Degeneration (AMD), Macular Oedema Secondary to Retinal Vein Occlusion (RVO), or Myopic Choroidal Neovascularization (mCNV)
Protocol code: SB11-2002
Sponsor: Samsung Bioepis Co. Ltd. (Pharmaceutical company). Phase: Therapeutic exploratory (Phase II). Countries: Poland (ended).
Therapeutic area(s): Diseases [C] - Eye Diseases [C11]
Gender: Female, Male. Age: 18-64 years, 65+ years. Enrolment: 30.
Status: Ended. Start date (EU): 2026-03-27. End date (EU): 2026-04-09. Decision date: 2025-06-01. Results received: No. Last updated: 2025-10-21.

Condition(s): Neovascular Age-Related Macular Degeneration (AMD), Macular Oedema Secondary to Retinal Vein Occlusion (RVO), Myopic Choroidal Neovascularization (mCNV)
Product: Byooviz 10 mg/ml solution for injection

Primary endpoint: Percentage of successful task completions on all of 12 tasks (Day 1)
Endpoint(s): Usability Endpoint • Percentage of successful completion on each of 12 tasks (Day 1), Safety Endpoint • Incidence of adverse events (AEs) and serious adverse events (SAEs) from Day 1 to Day 7, Efficacy Endpoint • Change from baseline in BCVA at Day 7

Source: https://euclinicaltrials.eu/ctis-public/view/2025-520599-24-00